EU clinical trial 2024-513388-16-00: PARACHUTES: Pedophilia At Risk – Acute Treatment – E-therapy vs SSRI
Sponsor: Karolinska University Hospital (Hospital/Clinic/Other health care facility). Phase: Therapeutic exploratory (Phase II). Countries: Sweden (ongoing, recruiting).
Therapeutic area(s): Psychiatry and Psychology [F] - Mental Disorders [F03]
Gender: Male. Age: 18-64 years. Enrolment: 111.
Status: Ongoing, recruiting. Start date (EU): 2024-06-17. Decision date: 2024-06-17. Results received: No. Last updated: 2024-06-17.

Condition(s): Pedophilic disorder
Product: FLUOXETINE

Primary endpoint: 14 weeks from randomization

Source: https://euclinicaltrials.eu/ctis-public/view/2024-513388-16-00